EU clinical trial 2023-504181-38-00: Assessment of microglial activation in patients with schizophrenia stratified for C4 complement by PET using [18F]DPA-714
Protocol code: C21-21
Sponsor: Institut National De La Sante Et De La Recherche Medicale (Laboratory/Research/Testing facility). Phase: Phase II and Phase III (Integrated). Countries: France (ongoing, recruiting).
Therapeutic area(s): Psychiatry and Psychology [F] - Mental Disorders [F03]; Diseases [C] - Pathological Conditions, Signs and Symptoms [C23]; Analytical, Diagnostic and Therapeutic Techniques and Equipment [E] - Investigative Techniques [E05]
Gender: Female, Male. Age: 18-64 years. Enrolment: 75.
Status: Ongoing, recruiting. Start date (EU): 2025-11-17. Decision date: 2023-05-26. Results received: No. Last updated: 2026-03-16.

Condition(s): pathology studied is schizophrenia
Product: 18F-DPA-714

Primary endpoint: The main evaluation criterion is the level of microglial activation measured in PET with [ 18F]-DPA714 in the brain, which will be compared between groups according to the genotype of C4 weighted by the ancestral haplotype that carries it
Endpoint(s): - Regional cortical thicknesses as determined on anatomical MRI, Parameters of subcortical brain connectivity (variables derived from diffusion MRI such as fractional anisotropy and resting functional MRI such as functional connectivity) which will be compared between groups according to the C4 genotype., Lipid abnormalities (cholesterol, serum triglycerides), blood glucose, peripheral markers of inflammation (CRP, cytokines) and clinical parameters (abdominal tension, abdominal girth) will also be correlated to the level of microglial activation measured in PET

Source: https://euclinicaltrials.eu/ctis-public/view/2023-504181-38-00